EU clinical trial 2024-516585-11-00: Efficacy of immunotherapy in melanoma patients with brain metastases treated with steroids. The MEMBRAINS trial
Sponsor: Region Hovedstaden (Hospital/Clinic/Other health care facility). Phase: Therapeutic exploratory (Phase II). Countries: Denmark (ongoing, recruiting).
Therapeutic area(s): Diseases [C] - Neoplasms [C04]
Gender: Female, Male. Age: 18-64 years, 65+ years. Enrolment: 41.
Status: Ongoing, recruiting. Start date (EU): 2018-06-12. Decision date: 2024-08-26. Results received: No. Last updated: 2026-05-07.

Condition(s): Advanced melanoma
Product: DABRAFENIB, TRAMETINIB, KEYTRUDA 25 mg/mL concentrate for solution for infusion, YERVOY 5 mg/ml concentrate for solution for infusion, ENCORAFENIB, OPDIVO 10 mg/mL concentrate for solution for infusion., BINIMETINIB

Primary endpoint: 6 months progression-free survival rate, 6 months overall survival rate
Endpoint(s): Overall progression-free survival, Overall survival, Overall response rate according to modified RECIST 1.1, Extracranial response rate in extracranial lesions according to modified RECIST 1.1, Intracranial response rate in intracranial lesions according to modified RECIST 1.1, Intracranial clinical benefit rate (CR+PR+SD) – proportion of patients with an overall complete, partial response or stable disease ≥ 6 months according to modified RECIST 1.1, Blood and tissue biomarkers of response and progression

Source: https://euclinicaltrials.eu/ctis-public/view/2024-516585-11-00